EU clinical trial 2024-514097-52-00: Impact of Inhaled BGF 160 on Complexity and Variability of Tidal Breathing and Oscillatory Mechanics in Stable COPD Patient
Protocol code: 2022/0422
Sponsor: Centre Hospitalier Universitaire De Lille (Hospital/Clinic/Other health care facility). Phase: Therapeutic use (Phase IV). Countries: France (authorised, recruiting).
Therapeutic area(s): Diseases [C] - Respiratory Tract Diseases [C08]
Gender: Female, Male. Age: 18-64 years, 65+ years. Enrolment: 35.
Status: Authorised, recruiting. Start date (EU): 2024-12-16. Decision date: 2024-12-16. Results received: No. Last updated: 2024-12-16.

Condition(s): Impact of inhaled BGF 160 on complexity and variability of tidal breathing and oscillatory mechanics in stable COPD patient
Product: Trixeo Aerosphere 5 micrograms/7.2 micrograms/160 micrograms pressurised inhalation, suspension

Primary endpoint: Multiple primary endpoints characterizing the change in ventilation pattern complexity and variability between V2 baseline (pre-treatment) and V3 peak (2 hours (+/-30min) post dose at one month) : noise limit, respiratory frequency, volume and largest Lyapounov component (an indicator of the sensitivity of the system to initial condition.
Endpoint(s): Change between V2 base (pre-treatment) and V3 peak (2 hours (+/-30min) post dose) of : - Impulse oscillometry or forced oscillation: resistances at 5Hz, reactance at 5Hz - Spirometry: Changes in FEV1 - Plethysmographic Functional residual capacity (FRC), Changes between V2 base measurement (pre-treatment) and V3 peak (2 hours (+/-30min) measurement for noise limit, respiratory frequency, volume, largest Lyapounov component, resistances at 5Hz, reactance at 5Hz, FEV1and FRC versus TDI at V3 (in term of continuous variable and in term of binary variable “responder/non responder”; a response is defined by a change in TDI ≥ +1 between baseline and V3), Dyspnea and symptom scores: - Baseline dyspnea index ( BDI) - Transition dyspnea index (TDI) - Modified dyspnea profile ( MDP) - CAT score - Likert scale for dyspnea and general health, Noise limit, respiratory frequency, volume, largest Lyapounov component, resistances at 5Hz, reactance at 5Hz, FEV1, FRC, and VAS dyspnea/chest tightness

Source: https://euclinicaltrials.eu/ctis-public/view/2024-514097-52-00